EU clinical trial 2024-511484-29-00: Effects of the ABCA1 inducer R3R01 on albuminuria levels in diabetic kidney disease
Protocol code: R3R01-DKD-201
Sponsor: River 3 Renal Corp. (Pharmaceutical company). Phase: Therapeutic exploratory (Phase II). Countries: Denmark (ongoing, recruiting).
Therapeutic area(s): Diseases [C] - Nutritional and Metabolic Diseases [C18]; Diseases [C] - Pathological Conditions, Signs and Symptoms [C23]
Gender: Female, Male. Age: 18-64 years, 65+ years. Enrolment: 60.
Status: Ongoing, recruiting. Start date (EU): 2024-10-09. Decision date: 2024-07-11. Results received: No. Last updated: 2026-04-28.

Condition(s): Diabetic kidney disease
Product: Technescan DTPA Radiofarmaceutisk præparationssæt, Placebo

Primary endpoint: Urinary albumin-to-creatinine ratio (UACR) (Change from randomization to end of treatment at 3 months)
Endpoint(s): Measured GFR with plasma clearance of 99Tc-DTPA or eGFR measured with the CKD-EPI equation based on creatinine and/or cystatin C, 24 hours ambulatory blood pressure, Plasma PK parameters of R3R01

Source: https://euclinicaltrials.eu/ctis-public/view/2024-511484-29-00